EU clinical trial 2023-508800-39-00: A Phase III, Open-label, Randomized Study of Osimertinib with or without Platinum Plus Pemetrexed Chemotherapy, as First-line Treatment in Patients with Epidermal Growth Factor Receptor (EGFR) Mutation-Positive, Locally Advanced or Metastatic Non-small Cell Lung Cancer (FLAURA2)
Protocol code: D5169C00001 FLAURA2
Sponsor: AstraZeneca AB (Pharmaceutical company). Phase: Therapeutic confirmatory (Phase III). Countries: Czechia (ongoing, recruitment ended), France (ongoing, recruitment ended).
Therapeutic area(s): Diseases [C] - Neoplasms [C04]
Gender: Female, Male. Age: 18-64 years, 65+ years. Enrolment: 27.
Status: Ongoing, recruitment ended. Start date (EU): 2020-09-29. Decision date: 2024-07-03. Results received: No. Last updated: 2025-02-24.
Decision dates by country: CZ: 2024-07-03, FR: 2024-07-03

Condition(s): Patients with locally-advanced or metastatic EGFRm (Ex19del and/or L858R) Non-Small Cell Lung Cancer.
Product: TAGRISSO 80 mg film-coated tablets, CARBOPLATIN, CISPLATIN, PEMETREXED

Primary endpoint: Progression-free survival (PFS) using Investigator assessment as defined by RECIST 1.1.
Endpoint(s): OS; Landmark OS at 1, 2, and 3 years; ORR, DoR; depth of response; DCR by Investigator, PFS2; TFST; TSST, Change from baseline and time to deterioration in EORTC QLQ-C30; Change from baseline and time to deterioration in EORTC QLQ-LC13, Steady-state plasma concentrations and appropriate PK parameters (CLss/F, Cmax,ss Cmin,ss and AUCss) of osimertinib and its metabolite, AZ5104 will be summarized., Concordance of EGFR mutation status between the local EGFR mutation test and the central cobas® EGFR Mutation Test v2 results from tumor samples with evaluable results., PFS by Investigator by plasma EGFR mutation status.

Source: https://euclinicaltrials.eu/ctis-public/view/2023-508800-39-00